EU clinical trial 2024-511508-18-00: An open-label, Phase 1/2, multicenter study of belumosudil in children aged 1 to <18 years requiring systemic treatment for active moderate-to-severe chronic graft versus host disease (cGVHD).
Protocol code: DFI17893
Sponsor: Sanofi-Aventis Recherche & Developpement (Pharmaceutical company). Phase: Phase I and Phase II (Integrated)- Other. Countries: France (ongoing, recruiting), Italy (ongoing, recruiting), Belgium (authorised, recruitment pending), Spain (authorised, recruitment pending), Netherlands (authorised, recruitment pending), Germany (authorised, recruitment pending).
Therapeutic area(s): Diseases [C] - Immune System Diseases [C20]
Gender: Female, Male. Age: 0-17 years, 18-64 years. Enrolment: 23.
Start date (EU): 2026-01-05. Decision date: 2025-09-30. Results received: No. Last updated: 2026-06-10.
Decision dates by country: BE: 2025-10-01, FR: 2025-09-30, DE: 2025-10-01, IT: 2025-10-01, ES: 2025-10-06, NL: 2025-10-01

Condition(s): Chronic graft versus host disease.
Product: belumosudil, SAR445761 - belumosudil

Primary endpoint: Phase 1: AUC, Phase 2: Proportion of participants who achieve an overall response (partial response [PR] or complete response [CR]) by Week 25 or Cycle 7 Day 1 whichever is first
Endpoint(s): Phase 1: Number of participants with treatment- emergent adverse events [TEAEs], serious TEAEs, and adverse events of special interest (AESIs), Phase 1: Cmax, Phase 1: AUC0-6h, Phase 1: ORR, Phase 1: DOR, Phase 1: response by organ, Phase 1: failure-free survival (FFS), Phase 1: overall survival (OS), Phase 1: time to response (TTR), Phase 2: Number of participants with treatment- emergent adverse events [TEAEs], serious TEAEs, and adverse events of special interest (AESIs), Phase 2: Ctrough of belumosudil, Phase 2: DOR, Phase 2: response by organ, Phase 2: FFS, Phase 2: OS, Phase 2: time to response (TTR), Phase 1: time to next treatment (TTNT), Phase 2: time to next treatment (TTNT)

Source: https://euclinicaltrials.eu/ctis-public/view/2024-511508-18-00